EU clinical trial 2025-524054-34-00: An Open-Label, Phase 3 Study to Evaluate the Efficacy and Safety of Salanersen (BIIB115) in Participants Aged 15-60 Years With Spinal Muscular Atrophy Who Are Either Treatment-Naïve or Have Previously Been Treated With Risdiplam
Protocol code: 277SM303
Sponsor: Biogen Idec Research Limited (Pharmaceutical company). Phase: Therapeutic confirmatory (Phase III). Countries: Finland (authorised, recruitment pending), Spain (authorised, recruitment pending), Italy (authorised, recruitment pending), Poland (authorised, recruitment pending), Ireland (authorised, recruitment pending), Germany (authorised, recruitment pending), France (authorised, recruitment pending).
Therapeutic area(s): Diseases [C] - Nervous System Diseases [C10]
Gender: Female, Male. Age: 0-17 years, 18-64 years. Enrolment: 40.
Status: Authorised, recruitment pending. Decision date: 2026-07-24. Results received: No. Last updated: 2026-07-31.
Decision dates by country: ES: 2026-07-29, DE: 2026-07-28, IE: 2026-07-31, FR: 2026-07-24, FI: 2026-07-28, IT: 2026-07-29, PL: 2026-07-29

Condition(s): Spinal Muscular Atrophy
Product: BIIB115

Primary endpoint: 1-1. Change From Baseline in Hammersmith Functional Motor Scale - Expanded (HFMSE) Total Score in Treatment-Naïve Cohort. The HFMSE is a tool used to assess motor function in individuals with SMA., 1-2. Participants will be asked to complete a specific movement and are then graded on the quality and execution of that movement. Higher scores indicate higher levels of motor ability. The overall score is the sum of the scores for all 33 items, with a maximum score of 66 with higher scores depicting better ability to perform activities. [Time Frame: At Month 12]
Endpoint(s): 1-1. Percentage of Participants With ≥ 3-Point Change From Baseline in HFMSE Total Score. The HFMSE is a tool used to assess motor function in individuals with SMA., 1-2. Participants will be asked to complete a specific movement and are then graded on the quality and execution of that movement. Higher scores indicate higher levels of motor ability. The overall score is the sum of the scores for all 33 items, with a maximum score of 66 with higher scores depicting better ability to perform activities. [Time Frame: Up to Day 1825], 2-1. Percentage of Participants With ≥ 2-Point Change From Baseline in Revised Upper Limb Module (RULM) Total Score. The RULM is developed to assess upper limb functional abilities of participants with SMA., 2-2. This test consists of a total of 20 upper limb performance items that are reflective of activities of daily living. The RULM is scored from 0 to 37 points, with higher scores indicating better function. [Time Frame: Up to Day 1825], 3-1. Percentage of Participants With ≥ 30-Meter Change From Baseline in 6-Minute Walk Test (6MWT) Distance (Ambulatory Participants Only)., 3-2. The 6MWT is a submaximal exercise test used to assess an individual’s functional exercise capacity. It measures the distance covered in 6 minutes on a flat, hard surface, providing valuable information about aerobic capacity and endurance [Time Frame: Up to Day 1825], 4-1. Change From Baseline in HFMSE Total Score. The HFMSE is a tool used to assess motor function in individuals with SMA. Participants will be asked to complete a specific movement and are then graded on the quality and execution of that movement., 4-2. Higher scores indicate higher levels of motor ability. The overall score is the sum of the scores for all 33 items, with a maximum score of 66 with higher scores depicting better ability to perform activities. [Time Frame: Up to Day 1825], 5. Change From Baseline in RULM Total Score. The RULM is developed to assess upper limb functional abilities of participants with SMA. This test consists of a total of 20 upper limb performance items that are reflective of activities of daily living. The RULM is scored from 0 to 37 points, with higher scores indicating better function. [Time Frame: Up to Day 1825], 6. Change From Baseline in Total 6MWT Distance (Ambulatory Participants Only). The 6MWT is a submaximal exercise test used to assess an individual’s functional exercise capacity. It measures the distance covered in 6 minutes on a flat, hard surface, providing valuable information about aerobic capacity and endurance. [Time Frame: Up to Day 1825], 7-1. Change From Baseline in Compound Muscle Action Potential (CMAP) Amplitudes. CMAP is a well validated method for tracking disease progression in neuromuscular disorders such as SMA and amyotrophic lateral sclerosis and has been proposed as a potential biomarker of a therapeutic effect in SMA., 7-2. CMAPs will be performed for the following nerve-muscle pairs: ulnar-abductor digiti minimi and peroneal-tibialis anterior. [Time Frame: Up to Day 1825], 8-1. Patient Global Impression of Change (PGI-C) Score. PGI-C is a self-reported 7-point scale evaluating the participant’s perception of change in disease state since baseline., 8-2. The scale ranges from 1 to 7, where 1= very much improved; 2= much improved; 3= minimally improved; 4= no change; 5= minimally worse; 6= much worse; or 7= very much worse. Lower scores indicate clinical improvement, and higher scores indicate disease worsening. [Time Frame: Up to Day 1825], 9-1. Change From Baseline in SMA Independence Scale - Upper Limb Module (SMAIS-ULM). The SMAIS-ULM is a validated tool designed to assess the level of independence in daily activities related to upper limb functionality for individuals with Type II and nonambulant Type III SMA., 9-2. The 22 items assess upper limb focused tasks across 5 domains of typical daily activities (bathing/hygiene, dressing, eating/drinking, picking up/moving objects, and other tasks) scored on a 3-point scale (0 = I cannot do this at all without help; 1 = I need some help; and 2 = I do not need help). Higher scores indicate greater independence. [Time Frame: Up to Day 1825], 10. Number of Participants with Adverse Events (AEs) and Serious Adverse Events (SAEs). [Time Frame: Up to Day 1825], 11. Concentration of Salanersen in Cerebrospinal Fluid (CSF). [Time Frame: Up to Day 1460], 12. Concentration of Salanersen in Serum. [Time Frame: Up to Day 1825]

Source: https://euclinicaltrials.eu/ctis-public/view/2025-524054-34-00